EU clinical trial 2024-515226-81-00: Ivabradine for PREVENTion of Myocardial Injury after Noncardiac Surgery (MINS) - PREVENT-MINS Trial
Protocol code: PREVENT-MINS
Sponsor: Uniwersytet Jagiellonski Collegium Medicum (Educational Institution). Phase: Therapeutic confirmatory (Phase III). Countries: Poland (ended).
Therapeutic area(s): Diseases [C] - Cardiovascular Diseases [C14]
Gender: Female, Male. Age: 18-64 years, 65+ years. Enrolment: 2500.
Status: Ended. Start date (EU): 2022-06-02. End date (EU): 2026-04-20. Decision date: 2024-11-05. Results received: No. Last updated: 2025-11-12.

Condition(s): Myocardial Injury after Noncardiac Surgery
Product: Ivabradine Anpharm 5 mg film-coated tablets, Placebo: lactose monohydrate, microcrystalline cellulose, native corn starch, colloidal anhydrous silica, maltodextrin, magnesium stearate Capsule: Beef gelatin, Glycerol, Titanium dioxide

Primary endpoint: Myocardial injury after non-cardiac surgery (MINS) defined as any myocardial infarction and any elevated postoperative cardiac troponin judged as resulting from myocardial ischaemia during or within 30 days after noncardiac surgery
Endpoint(s): Secondary outcomes at 30 days include: a composite of vascular death, non-fatal MINS, non-fatal stroke, and non-fatal cardiac arrest; vascular death; MINS not fulfilling the criteria of myocardial infarction; myocardial infarction; days alive and at home; stroke, health-related quality of life; cancellation/postponement of surgery on the day of surgery due to HR concerns; intraoperative mean arterial pressure; intraoperative heart rate; clinically important atrial fibrillation; safety outcomes including clinically significant bradycardia, clinically significant hypotension and phosphenes.

Source: https://euclinicaltrials.eu/ctis-public/view/2024-515226-81-00